EU clinical trial 2022-502757-34-00: An Open-Label, Multicenter, Multi-Arm Phase 1 Study Evaluating the Safety and Pharmacokinetics of ADU-1805 in Adults with Advanced Solid Tumors
Protocol code: SRP-22C102
Sponsor: Sairopa B.V. (Pharmaceutical company). Phase: Human Pharmacology (Phase I)- First administration to humans. Countries: Spain (ongoing, recruiting), Belgium (ongoing, recruiting), France (ongoing, recruiting), Poland (ongoing, recruiting).
Therapeutic area(s): Diseases [C] - Neoplasms [C04]
Gender: Female, Male. Age: 18-64 years, 65+ years. Enrolment: 77.
Status: Ongoing, recruiting. Start date (EU): 2024-08-20. Decision date: 2023-07-31. Results received: No. Last updated: 2026-06-25.
Decision dates by country: PL: 2023-08-10, FR: 2023-10-17, ES: 2023-07-25, BE: 2023-07-31

Condition(s): Advanced solid tumors

Source: https://euclinicaltrials.eu/ctis-public/view/2022-502757-34-00